EU clinical trial 2024-519713-65-00: A Phase II, Open Label, Multicenter, Single Arm Study of WSD0922-FU for Patients with Locally Advanced or Metastatic Non-Small Cell Lung Cancer whose Disease has Progressed with First-Line Osimertinib Treatment and whose Tumors harbor a C797S mutation within the Epidermal Growth Factor Receptor Gene
Protocol code: WS2202
Sponsor: Wayshine Biopharm Inc. (Pharmaceutical company). Phase: Therapeutic exploratory (Phase II). Countries: France (ongoing, recruiting).
Therapeutic area(s): Diseases [C] - Neoplasms [C04]
Gender: Female, Male. Age: 18-64 years, 65+ years. Enrolment: 10.
Status: Ongoing, recruiting. Start date (EU): 2025-09-04. Decision date: 2025-07-18. Results received: No. Last updated: 2026-06-29.

Condition(s): Non-Small Cell Lung Cancer
Product: WSD0922-FU, WSD0922-FU

Primary endpoint: To determine the recommended phase 2 dose [RP2D] and Objective Response Rate (ORR).
Endpoint(s): 1. To further assess the efficacy of WSD0922-FU in terms of: - Progression Free Survival (PFS) - Duration of Response (DoR) - Disease Control Rate (DCR) - Change in Tumor Size - Overall Survival (OS)

Source: https://euclinicaltrials.eu/ctis-public/view/2024-519713-65-00